EU clinical trial 2024-511412-25-00: A Phase II study of pembrolizumab, lenvatinib and chemotherapy combination in first line extensive-stage small cell lung cancer (PEERS)
Sponsor: Fundacion GECP (Patient organisation/association). Phase: Therapeutic exploratory (Phase II). Countries: Spain (ongoing, recruitment ended).
Therapeutic area(s): Diseases [C] - Neoplasms [C04]
Gender: Female, Male. Age: 18-64 years, 65+ years. Enrolment: 46.
Status: Ongoing, recruitment ended. Start date (EU): 2022-11-07. Decision date: 2024-03-19. Results received: No. Last updated: 2026-08-06.

Condition(s): First line treatment for extensive-stage small cell lung cancer small cell lung cancer patients (ES-SCLC)
Product: Lenvatinib, KEYTRUDA 25 mg/mL concentrate for solution for infusion

Primary endpoint: Part 1: * Safety and tolerability Dose-limiting toxicities (DLTs), adverse events (AEs) and study intervention discontinuations due to AEs. Part 2: • Progression-free Survival (PFS) per RECIST 1.1 assessed by investigator, Part 2: • Progression-free Survival (PFS) per RECIST 1.1 assessed by investigator
Endpoint(s): Part 1 (for patients treated at part 2): Objective response per RECIST 1.1 based on investigator, Part 1 (for patients treated at part 2): Duration of response (DOR) per RECIST 1.1 based on investigator, Part 1 (for patients treated at part 2): Overall Survival, Part 2: Objective response per RECIST 1.1 based on investigator, Part 2: DOR per RECIST 1.1 based on investigator, Part 2: Safety and tolerability, Part 2: Overall Survival

Source: https://euclinicaltrials.eu/ctis-public/view/2024-511412-25-00